EU clinical trial 2025-520777-39-00: Evaluation of a Therapeutic Strategy to Shorten Hospital Stay in Complicated Pediatric Appendicitis: A Randomized, Parallel, Multicenter, Open-Label Clinical Trial
Protocol code: IIBSP-FAS-2020-120
Sponsor: Fundacio Institut De Recerca De L'Hospital De La Santa Creu I Sant Pau (Hospital/Clinic/Other health care facility). Phase: Therapeutic use (Phase IV). Countries: Spain (ongoing, recruiting).
Therapeutic area(s): Diseases [C] - Pathological Conditions, Signs and Symptoms [C23]; Analytical,Diagnostic,Therapeutic Techniques and Equipment [E]-Surgical Procedures, Operative [E04]; Diseases [C] - Bacterial Infections and Mycoses [C01]
Gender: Female, Male. Age: 0-17 years. Enrolment: 772.
Status: Ongoing, recruiting. Start date (EU): 2025-01-29. Decision date: 2025-01-29. Results received: No. Last updated: 2026-05-12.

Condition(s): Complicated acute appendicitis
Product: Amoxicilina/Ácido clavulánico NORMON 1.000 mg/200 mg polvo para solución inyectable y para perfusión EFG, Amoxicilina/Ácido clavulánico NORMON 875 mg/125 mg comprimidos recubiertos con película EFG

Primary endpoint: The primary outcome measure will be the composite variable "adverse events" occurring within the first 30 postoperative days, defined as the occurrence of any of the following events: intra-abdominal abscess, peritonitis, surgical wound complications, reoperation, sepsis, or death.

Source: https://euclinicaltrials.eu/ctis-public/view/2025-520777-39-00